EU clinical trial 2024-518370-14-00: Electrochemotherapy with Carboplatinum plus Bleomycin versus Bleomycin alone in vulvar cancer: the ElechtraPlatinum Study. A Randomized Controlled Trial
Protocol code: ElechtraPlatinum
Sponsor: Azienda Ospedaliero-Universitaria Di Bologna IRCCS Istituto Di Ricerca E Di Cura A Carattere Scientifico (Hospital/Clinic/Other health care facility). Phase: Therapeutic exploratory (Phase II). Countries: Italy (authorised, recruitment pending).
Therapeutic area(s): Diseases [C] - Neoplasms [C04]
Gender: Female. Age: 18-64 years, 65+ years. Enrolment: 92.
Status: Authorised, recruitment pending. Decision date: 2024-11-27. Results received: No. Last updated: 2024-11-27.

Condition(s): relapsing vulvar carcinoma already subjected to multiple treatments
Product: BLEOPRIM 15 mg polvere per soluzione iniettabile, Carboplatino AHCL 10 mg/ml Concentrato per soluzione per infusione

Primary endpoint: local progression free survival

Source: https://euclinicaltrials.eu/ctis-public/view/2024-518370-14-00